EU clinical trial 2024-515024-37-00: A Phase 3, Multicenter, Randomized, Double-blind, Placebo-Controlled Study to Evaluate the Efficacy and Safety of Mitapivat in Pediatric Subjects With Pyruvate Kinase Deficiency Who Are Regularly Transfused, Followed by a 5-Year Open-label Extension Period
Protocol code: AG348-C-022
Sponsor: Agios Pharmaceuticals Inc. (Pharmaceutical company). Phase: Therapeutic confirmatory (Phase III). Countries: Spain (ended), Denmark (ongoing, recruitment ended), Netherlands (ended), Czechia (ongoing, recruitment ended).
Therapeutic area(s): Diseases [C] - Hemic and Lymphatic Diseases [C15]
Gender: Female, Male. Age: 0-17 years. Enrolment: 11.
Start date (EU): 2022-05-27. Decision date: 2024-08-12. Results received: No. Last updated: 2025-11-19.
Decision dates by country: NL: 2024-08-12, ES: 2024-09-05, CZ: 2024-08-13, DK: 2024-08-20

Condition(s): Pyruvate Kinase Deficiency
Product: MITAPIVAT, Placebo for MITAPIVAT, MITAPIVAT, MITAPIVAT, MITAPIVAT

Primary endpoint: Transfusion reduction response (TRR), defined as achievement of a ≥33% reduction in the total red blood cell (RBC) transfusion volume from Week 9 through Week 32 of the Double-blind Period normalized by weight and actual study drug duration compared with the historical transfusion volume standardized by weight and to 24 weeks

Source: https://euclinicaltrials.eu/ctis-public/view/2024-515024-37-00